EU clinical trial 2023-503956-29-00: CA209-8HW A Phase 3 Randomized Clinical Trial of Nivolumab alone, Nivolumab in Combination with Ipilimumab, or Investigator’s Choice Chemotherapy in Participants with Microsatellite Instability High (MSI-H) or Mismatch Repair Deficient (dMMR) Metastatic Colorectal Cancer
Protocol code: CA209-8HW
Sponsor: Bristol-Myers Squibb Services Unlimited Company (Pharmaceutical company). Phase: Therapeutic confirmatory (Phase III). Countries: Austria (ended), Italy (ended), Spain (ended), Norway (ended), Romania (ended), Netherlands (ended), Belgium (ended), France (ended), Greece (ended), Germany (ended), Czechia (ended), Denmark (ended).
Therapeutic area(s): Diseases [C] - Neoplasms [C04]
Gender: Female, Male. Age: 18-64 years, 65+ years. Enrolment: 571.
Status: Ended. Start date (EU): 2019-08-26. End date (EU): 2026-04-20. End date: 2026-04-24. Decision date: 2024-04-05. Results received: No. Last updated: 2026-05-08.
Decision dates by country: AT: 2024-05-02, BE: 2024-04-18, CZ: 2024-04-09, DK: 2024-04-05, FR: 2024-04-05, DE: 2024-04-08, GR: 2024-05-22, IT: 2024-04-08, ES: 2024-04-08, RO: 2024-04-10, NO: 2024-04-09, NL: 2024-04-05

Condition(s): Microsatellite Instability High (MSI-H) or Mismatch Repair Deficient Metastatic Colorectal Cancer (dMMR)
Product: YERVOY 5 mg/ml concentrate for solution for infusion, OPDIVO 10 mg/mL concentrate for solution for infusion., YERVOY 5 mg/ml concentrate for solution for infusion, Irinotecan Bendalis 20 mg/ml Konzentrat zur Herstellung einer Infusionslösung, FLUOROURACIL, OPDIVO 10 mg/mL concentrate for solution for infusion., Avastin 25 mg/ml concentrate for solution for infusion, DISODIUM FOLINATE

Primary endpoint: Progression-Free Survival (PFS) by Blinded Independent Central Review (BICR) (arm B vs A, all lines, centrally confirmed), PFS by BICR (arm B vs C, 1L, centrally confirmed)
Endpoint(s): Overall Response Rate (ORR) by BICR (arm B vs A, all lines, centrally confirmed), Overall Survival (OS) (arm B vs A, all lines, centrally confirmed), PFS by Investigator Assessment (arm B vs A, all lines, centrally confirmed), PFS by BICR among all randomized participants (arm B vs A, all lines, per local testing), PFS by BICR (arm B vs A, 1L, centrally confirmed), ORR by BICR (arm B vs C, 1L, centrally confirmed), ORR by BICR (arm B vs A, 1L, centrally confirmed), OS (arm B vs A, 1L, centrally confirmed), PFS by BICR (arm A vs C, 1L, centrally confirmed), OS (arm B vs C, 1L, centrally confirmed), ORR by BICR (arm A vs C, 1L, centrally confirmed), OS (arm A vs C, 1L, centrally confirmed), PFS by Investigator (arm A, B and C, 1L, centrally confirmed), PFS by BICR among all randomized participants who have not received prior treatment (arm B vs C, 1L, per local testing), PFS by BICR among all randomized participants who have not received prior treatment (arm B vs A, 1L, per local testing), PFS by BICR (arm B vs C, 1L, by each central test), PFS by BICR (arm B vs A, all lines, by each central test), PFS by BICR (crossover cohort, centrally confirmed), ORR by BICR (crossover cohort, centrally confirmed)

Source: https://euclinicaltrials.eu/ctis-public/view/2023-503956-29-00